EU clinical trial 2024-512727-36-00: Escalated single Platelet Inhibition for one month plus Direct oral anticoagulation in patients with Atrial fibrillation and acUte coRonary syndrome undergoing percutaneoUS coronary intervention (EPIDAURUS)
Protocol code: EPIDAURUS-2020
Sponsor: Klinikum der Universitaet Muenchen AöR (Hospital/Clinic/Other health care facility). Phase: Therapeutic use (Phase IV). Countries: Austria (ended), Germany (ended).
Therapeutic area(s): Diseases [C] - Cardiovascular Diseases [C14]
Gender: Female, Male. Age: 18-64 years, 65+ years. Enrolment: 1474.
Status: Ended. Start date (EU): 2021-12-21. End date (EU): 2026-03-03. Decision date: 2024-10-11. Results received: No. Last updated: 2026-03-05.
Decision dates by country: AT: 2024-10-20, DE: 2024-10-11

Condition(s): Patients with atrial fibrillation and ST-segment elevation myocardial infarction (STEMI) or non-ST-segment elevation myocardial infarction (NSTEMI) (biomarker -positive acute coronary syndrome) undergoing PCI
Product: PRASUGREL, CLOPIDOGREL, TICAGRELOR, ACETYLSALICYLIC ACID

Primary endpoint: Primary efficacy endpoint: Major ischaemic events defined as the composite of all-cause mortality, myocardial infarction, definite or probable stent thrombosis, ischaemic stroke or systemic thromboembolism (superiority test) at 6 weeks after randomization, Primarys safety endpoint: Bleeding type 2 or higher according to the Bleeding Academic Research Consortium (BARC) criteria (non-inferiority test) at 6 weeks after randomization
Endpoint(s): All individual components of the primary endpoint (all-cause mortality, myocardial infarction, definite or probable stent thrombosis, ischaemic stroke, systemic thromboembolism) at 6 weeks after randomization, Cardiovascular mortality at 6 weeks after randomization, Bleeding (BARC type ≥ 2) at 6 weeks after randomization, Urgent revascularization at 6 weeks after randomization, All-cause mortality at 6 months after randomization, Unplanned hospitalization due to acute heart failure or acute coronary syndrome at 6 months after randomization, Ischaemic stroke at 6 months after randomization

Source: https://euclinicaltrials.eu/ctis-public/view/2024-512727-36-00